EU clinical trial 2024-513360-25-00: Randomised Controlled Clinical Trial Investigating the Effect of Reduced Bleomycin in Electrochemotherapy Treatment on Patients with Cutaneous Malignancies (The Bless trial)
Sponsor: Region Sjaelland (Hospital/Clinic/Other health care facility). Phase: Phase III and phase IV (Integrated). Countries: Denmark (ongoing, recruiting).
Therapeutic area(s): Diseases [C] - Neoplasms [C04]
Gender: Female, Male. Age: 18-64 years, 65+ years. Enrolment: 55.
Status: Ongoing, recruiting. Start date (EU): 2024-10-29. Decision date: 2024-07-01. Results received: No. Last updated: 2026-03-20.

Condition(s): Any cancer with cutaneous malignancies
Product: BLEOMYCIN

Primary endpoint: The primary endpoint of this study is to evaluate the clinical overall response rate of ECT treatment of cutaneous malignancies after three months.
Endpoint(s): Treatment response for normal dose group, reduced dose group, and for all treated tumours at optional time points using RECIST criteria, digital photography and ruler., Aesthetic outcome for normal dose group, reduced dose group and for all tumours after the time periods 2 to 6 months and 6 to 12 months, using the Vancouver Scar Scale and Patient and Observer Scar Assessment Scale (POSAS)., Complete and partial remissions for all patients treated (patient level), i.e. number of patients experiencing objective responses on at least one treated tumour., Biopsy after 12 months (optional) for histological examination of malignancy presence (HE stain, and staining for specific tumour markers can be included)., All-cause mortality and cancer related mortality within 12 months., Quality of life before treatment and at approximately 3 months. a. EORTC questionnaire C30 (all patients) – data from normal dose group, reduced dose group, and for the whole population will be registered and compared. b. Qualitative interviews (optional, subset of patients) – descriptive list of symptoms from normal dose group, reduced dose group, and for the whole population will be registered and compared., Relation between tumour histology Response rates and response duration according to tumour histology – data from normal dose group, reduced dose group, and for the study population will be registered and compared., Response rates and response duration in tumours according to size (≤3cm or > 3cm) – data from normal dose group, reduced dose group, and for the whole population will be registered and compared., Side effects according to CTCAE according to treatment dose – data from normal dose group, reduced dose group, and for the whole population will be registered and compared., The emergence of pain due to cutaneous malignancies, assessed using Numeric Rating Scale (NRS)., Pharmacokinetics (blood samples at 0, 5, 10, 20, 30 and 40 minutes after bleomycin infusion) will be analysed depending on age, treatment dose, Body Surface Area (BSA), kidney function (eGFR panel)., Bleomycin concentration in tumour (UHPLC-ESI-MS), including concentration vs time., In order to examine if the faction of tumour cells in tumour biopsies matters for the bleomycin concentration at measured time points (0,2, 4, 6, 8 minutes after bleomycin infusion) the concentration of bleomycin in tumour tissue from the normal dose group, the reduced dose group, and for the whole population will be analysed and compared

Source: https://euclinicaltrials.eu/ctis-public/view/2024-513360-25-00